EU clinical trial 2023-507062-34-00: Phase I/II, open label, multicenter study of rapcabtagene autoleucel in adult patients with CLL/SLL, 3L+ DLBCL, r/r ALL and 1L HR LBCL
Protocol code: CYTB323A12101
Sponsor: Novartis Pharma AG (Pharmaceutical company). Phase: Phase I and Phase II (Integrated)- First administration to humans. Countries: France (ongoing, recruitment ended), Spain (ongoing, recruitment ended), Germany (ongoing, recruitment ended), Austria (ongoing, recruitment ended), Italy (ongoing, recruitment ended).
Therapeutic area(s): Diseases [C] - Neoplasms [C04]
Gender: Female, Male. Age: 18-64 years, 65+ years. Enrolment: 142.
Status: Ongoing, recruitment ended. Start date (EU): 2020-08-07. Decision date: 2024-07-29. Results received: No. Last updated: 2026-07-08.
Decision dates by country: DE: 2024-08-01, ES: 2024-07-29, IT: 2024-08-05, AT: 2024-08-05, FR: 2024-08-01

Condition(s): Chronic lymphocytic leukemia/Small lymphocytic lymphoma, High-Risk large B-Cell lymphoma, Acute lymphoblastic leukemia, Diffuse large B-Cell lymphoma
Product: CYCLOPHOSPHAMIDE MONOHYDRATE, IBRUTINIB, BENDAMUSTINE HYDROCHLORIDE, FLUDARABINE PHOSPHATE, TOCILIZUMAB, ETOPOSIDE, CYTARABINE, YTB323

Primary endpoint: Phase I part - CLL/SLL, 3L+ DLBCL, ALL: - Incidence and nature of Dose Limiting Toxicities during the first 28 days after rapcabtagene autoleucel infusion (Dose Escalation part only) Incidence and severity of AEs and SAEs, including changes in laboratory values, ECG and vital signs after rapcabtagene autoleucel infusion., Phase I part - CLL/SLL, 3L+ DLBCL, ALL: - Ibrutinib dose modifications following rapcabtagene autoleucel infusion., Phase I part - CLL/SLL, 3L+ DLBCL, ALL: - Manufacture success rate (defined as number of participants with product that meets release specifications and at or above the planned target dose divided by total number of patients enrolled)., Phase II part – 3L+ DLBCL: - CRR defined as BOR of CR after rapcabtagene autoleucel infusion as per Lugano criteria., Phase II part – 1L HR LBCL: - CRR defined as BOR of CR after rapcabtagene autoleucel infusion as per Lugano criteria.
Endpoint(s): Phase I part - CLL/SLL, 3L+ DLBCL and ALL: - qPCR-detected rapcabtagene autoleucel transgene concentrations over time in peripheral blood and relevant tissues., Phase I part - CLL/SLL, 3L+ DLBCL, ALL: - Pre-existing and treatment induced immunogenicity (cellular and humoral) of rapcabtagene autoleucel., Phase I part - CLL/SLL: - BOR of CR/PR per iwCLL response criteria Duration of response (DOR), i.e., time from first achievement of CR/PR after rapcabtagene autoleucel infusion until first documented disease progression or death due to any cause., Phase I part - 3L+ DLBCL: - BOR of CR/PR as per Lugano criteria. Complete response rate (CRR) at months 3 and 6 DOR., Phase I part - ALL: - BOR of CR/Cri. Disease response (CR/Cri) at month 3 and 6. DOR, defined as the time from achievement of CR or Cri to relapse or death due to any cause. EFS, defined as the date from rapcabtagene autoleucel infusion to the earliest date of relapse after CR/Cri, treatment failure (defined as failure to achieve CR/Cri within 12 weeks of infusion), or death due to any cause., Phase I part – ALL: - MRD negative status by flow cytometry., Phase II part – 3L+ DLBCL: - Overall response rate (ORR) defined as BOR of CR/PR as per Lugano criteria., Phase II part – 3L+ DLBCL: - CRR at months 3 and 6., Phase II part – 3L+ DLBCL: - Duration of response (DOR), defined as time from first CR/PR to first documented progression or death due to any cause., Phase II part – 3L+ DLBCL: - Progression-free survival (PFS) defined as time from rapcabtagene autoleucel infusion to first documented progression or death due to any cause., Phase II part – 3L+ DLBCL: - Overall survival (OS), defined as time from date of rapcabtagene autoleucel infusion to date of death due to any cause., Phase II part – 3L+ DLBCL: - Incidence and severity of AEs and SAEs, including changes in laboratory values, ECG and vital signs after rapcabtagene autoleucel infusion., Phase II part – 3L+ DLBCL: - qPCR-detected rapcabtagene autoleucel transgene concentrations over time in peripheral blood and relevant tissues., Phase II part – 3L+ DLBCL: - Pre-existing and treatment induced immunogenicity (cellular and humoral) of rapcabtagene autoleucel., Phase II part – 3L+ DLBCL: - Time from apheresis completion until return of rapcabtagene autoleucel product to the clinic or hospital., Phase II part – 1L HR LBCL: - Overall response rate (ORR) defined as BOR of CR/PR as per Lugano criteria., Phase II part – 1L HR LBCL: - CRR at months 6 and 12., Phase II part – 1L HR LBCL: - Duration of response (DOR). Defined as time from first CR/PR to first documented progression or death due to any cause., Phase II part – 1L HR LBCL: - Progression-free survival (PFS) defined as time from rapcabtagene autoleucel infusion to first documented progression or death due to any cause., Phase II part – 1L HR LBCL: - Event-free survival (EFS) defined as time from rapcabtagene autoleucel infusion to first documented progression, start of new anti-lymphoma therapy, biopsy-proven residual disease on or after month 6, or death due to any cause., Phase II part – 1L HR LBCL: - Overall survival (OS), defined as time from date of rapcabtagene autoleucel infusion to date of death due to any cause., Phase II part – 1L HR LBCL: - Within each subgroup: CRR, ORR CRR at months 6 and 12 DOR, PFS, EFS, OS, Phase II part – 1L HR LBCL: - Incidence and severity of AEs and SAEs, including changes in laboratory values, ECG and vital signs after rapcabtagene autoleucel infusion., Phase II part – 1L HR LBCL: - qPCR-detected rapcabtagene autoleucel transgene concentrations over time in peripheral blood and relevant tissues., Phase II part – 1L HR LBCL: - Pre-existing and treatment induced immunogenicity (cellular and humoral) of rapcabtagene autoleucel., Phase II part – 1L HR LBCL: - Time from apheresis completion until return of rapcabtagene autoleucel product to the clinic or hospital.

Source: https://euclinicaltrials.eu/ctis-public/view/2023-507062-34-00